EU clinical trial 2023-506408-18-00: An open label, balanced, randomized, single dose, two treatment, two period, two sequence, crossover, bioequivalence study comparing Dapagliflozin tablets 10mg, manufactured by Sun Pharmaceutical Industries Limited, India with Forxiga (Dapagliflozin) film-coated tablets 10 mg, manufactured by AstraZeneca AB Gärtunavägen, SE-151 85 Södertälje Sweden, in healthy adult, human subjects under fasting condition
Protocol code: DAPAG-02-23
Sponsor: Sun Pharmaceutical Industries Limited (Pharmaceutical company). Phase: Human Pharmacology (Phase I)- Bioequivalence Study. Countries: Romania (ended).
Therapeutic area(s): Diseases [C] - Nutritional and Metabolic Diseases [C18]
Gender: Female, Male. Age: 18-64 years. Enrolment: 48.
Status: Ended. Start date (EU): 2023-11-21. End date (EU): 2023-12-21. Decision date: 2023-11-09. Results received: Yes. Last updated: 2023-11-09.

Condition(s): diabetes
Product: Dapagliflozin tablets 10 mg, Forxiga 10 mg film-coated tablets

Primary endpoint: Cmax, AUC0-t
Endpoint(s): AUC0-inf, AUC_%Extrap, AUC0-t/AUC0-∞, Tmax, Kel, T1/2

Source: https://euclinicaltrials.eu/ctis-public/view/2023-506408-18-00